EU clinical trial 2024-513981-21-00: Antibody Glycosylation dynamics After Vaccination (AGAVE)
Sponsor: Leids Universitair Medisch Centrum (LUMC) (Hospital/Clinic/Other health care facility). Phase: Therapeutic use (Phase IV). Countries: Netherlands (ongoing, recruiting).
Therapeutic area(s): Diseases [C] - Respiratory Tract Diseases [C08]
Gender: Female, Male. Age: 18-64 years. Enrolment: 60.
Status: Ongoing, recruiting. Start date (EU): 2025-09-19. Decision date: 2025-05-26. Results received: No. Last updated: 2025-08-11.

Condition(s): healthy individuals
Product: Vaxigrip Tetra, suspensie voor injectie in een voorgevulde spuit Quadrivalent griepvaccin (gesplitst virion, geïnactiveerd), Fluenz Tetra nasal spray suspension Influenza vaccine (live attenuated, nasal)

Primary endpoint: The main endpoint is the fold change in influenza specific IgA levels in nasal fluid of healthy individuals at day 21 after receiving an intranasal influenza vaccination compared to an intramuscular influenza vaccination.
Endpoint(s): Determination of influenza-specific IgA and IgG glycosylation in nasal fluid and blood and correlated this with the total IgA and IgG glycosylation in both groups [timeframe: Baseline, 1-10, 14, 21, and 70 days after vaccination]., Correlate antibody (IgA and IgG) concentrations in nasal fluid and blood after vaccination in both groups [timeframe: Baseline, 1-10, 14, 21, and 70 days after vaccination]., Profiling of glycosylation of total and antigen-specific IgG and IgA in saliva in each group and correlated this to results in blood and nasal fluid [timeframe: Baseline, 1-10, 14, 21, and 70 days after vaccination]., Transcriptomic profiling (single-cell RNA-sequencing (scRNA-seq) and B-cell receptor sequencing (BCRseq) of B cells in the nasopharyngeal samples and blood in both groups. [Timeframe: baseline, 7,14,21, and 70 days after vaccination]., In dept (gene expression) profiling of (innate) immune cells, e.g. glycosyltransferase expression and spectral flow panels in the nasopharyngeal adenoid samples and blood in each group and correlate this between the two compartments [timeframe: Baseline, 7, 14, 21, and 70 days after vaccination]., In dept molecular detection of microbiota and the presence of viral infections in each group [timeframe: Baseline, 7, 14, 21, and 70 days after vaccination]., Analysis of secreted immune mediators (e.g. cytokines, antimicrobial defence molecules, antibodies and metabolites) in nasal lining fluid, saliva, and blood of each group and the correlate with (innate) immune cells and antibody glycosylation [timeframe: Baseline, 1-10, 14, 21, and 70 days after vaccination]., Association of antibody glycosylation with covariates, such as biological age and sex, (innate) immune populations, and other immune parameters [timeframe: Baseline, 1-10, 14, 21, and 70 days after vaccination]., Correlation of host immune response after intranasal vaccination (this study) with the host immune response in a cohort of children that received a LIAV (LION study)., Nasal shedding of all four strains of influenza post-LAIV, measured using daily collected nasosorptions and analyzed with RT-PCR techniques [timeframe: Baseline, 1-10 days after vaccination]., Explorative endpoint: Transcriptomic cluster composition, as frequency of T cells subsets, and clonality of nasal (inferior turbinate) and blood T cell populations in both groups [timeframe: Baseline, 7, 14, 21, and 70 days after vaccination]., Explorative endpoint: In dept (gene expression) profiling of (innate) immune cells, e.g. Activator Induced Marker (AIM)-assays and spectral flow panels in the inferior turbinate and blood in each group and correlate this between compartments [timeframe: Baseline, 7, 14, 21, and 70 days after vaccination].

Source: https://euclinicaltrials.eu/ctis-public/view/2024-513981-21-00